EU clinical trial 2024-517547-31-00: A placebo-controlled, single-blind, phase I study in healthy volunteers and patients with Rheumatoid Arthritis with ABO21009
Protocol code: ABO21009-101
Sponsor: Aboleris Holdco (Pharmaceutical company). Phase: Human Pharmacology (Phase I)- First administration to humans. Countries: Netherlands (ongoing, recruiting), Belgium (ongoing, recruiting), Germany (authorised, recruiting).
Therapeutic area(s): Diseases [C] - Immune System Diseases [C20]
Gender: Female, Male. Age: 18-64 years, 65+ years. Enrolment: 78.
Start date (EU): 2025-01-31. Decision date: 2025-01-31. Results received: No. Last updated: 2026-06-15.
Decision dates by country: BE: 2025-08-14, DE: 2026-03-10, NL: 2025-01-31

Condition(s): Rheumatoid Arthritis

Source: https://euclinicaltrials.eu/ctis-public/view/2024-517547-31-00